EU clinical trial 2024-520373-12-00: Fecal microbiota transplantation in patients receiving infliximab and vedolizumab for ulcerative colitis: A randomized controlled trial
Sponsor: Varsinais-Suomen hyvinvointialue (Hospital/Clinic/Other health care facility). Phase: Therapeutic use (Phase IV). Countries: Finland (authorised, recruitment pending).
Therapeutic area(s): Diseases [C] - Digestive System Diseases [C06]
Gender: Female, Male. Age: 18-64 years, 65+ years. Enrolment: 40.
Status: Authorised, recruitment pending. Decision date: 2025-01-21. Results received: No. Last updated: 2025-01-21.

Condition(s): Ulcerative Colitis, Crohn´s disease
Product: Entyvio 300 mg powder for concentrate for solution for infusion, Zessly 100 mg powder for concentrate for solution for infusion, Remsima 120 mg solution for injection in pre-filled pen, Entyvio 108 mg solution for injection in pre-filled pen

Primary endpoint: Steroid free clinical remission at week 14 from first fecal microbiota transplant and week 12 from the first infliximab/vedolizumab infusion. Clinical remission here is defined as a total score of ≤2 on the Mayo scale and no subscore >1 on any of the four components.
Endpoint(s): Endoscopic healing defined as endoscopic Mayo subscore of 0, Endoscopic improvement defined as Mayo endoscopic subscore of 0 or 1, Improvement in quality of life (defined as an increase of ≥16 points in IBDQ score), Histologic remission, Fecal calprotectin, Weight, Blood pressure, Clinical response defined as a reduction in the partial Mayo score (stool frequency, rectal bleeding, and physician's global assessment) of ≥2 points and of ≥25% from baseline, with an accompanying decrease in rectal bleeding subscore of ≥1 point or absolute rectal bleeding subscore of ≤1 point., Adherence to FMT, Adverse events

Source: https://euclinicaltrials.eu/ctis-public/view/2024-520373-12-00